EU clinical trial 2024-513545-37-00: REDUCE PMR: Rituximab Effect on Decreasing glUcoCorticoid Exposition in relapsing PolyMyalgia Rheumatica
Sponsor: Sint Maartenskliniek Stichting (Hospital/Clinic/Other health care facility). Phase: Therapeutic use (Phase IV). Countries: Netherlands (ongoing, recruitment ended).
Therapeutic area(s): Diseases [C] - Musculoskeletal Diseases [C05]; Analytical, Diagnostic and Therapeutic Techniques and Equipment [E] - Therapeutics [E02]
Gender: Female, Male. Age: 18-64 years, 65+ years. Enrolment: 174.
Status: Ongoing, recruitment ended. Start date (EU): 2023-02-09. Decision date: 2024-11-21. Results received: No. Last updated: 2025-03-05.

Condition(s): Polymyalgia rheumatica
Product: RITUXIMAB

Primary endpoint: The proportion of patients in GC free remission one year after RTX treatment compared to placebo
Endpoint(s): Proportion of patients in GC free remission at week 21, Proportion of patients with low dose GC (≤5mg/day) remission at week 21, week 52, 1.5 year and 2 years., PMR-AS at each visit, The number of disease relapses/recurrences up to week 52, The proportion of patients with a disease relapse/recurrence at week 52, The time from baseline to GC free remission and to relapse, GC cumulative dose at 52 weeks, 1.5 and 2 years., Proportion of patients with RTX/PCB retreatment, Proportion of patients who start methotrexate, leflunomide, tocilizumab or sarilumab or possible other bDMARD being registered for PMR, Sex differences in frequencies of GC-remission and adverse events, Changes in patient reported outcomes, concerning pain, fatigue, stiffness and physical function (as recommended by the OMERACT), Medical consumption and productivity loss, (Changes in) modified glucocorticoid toxicity index (which excludes bone mineral density scan to improve feasibility), Frequency, types, proportion of patients with, and total numbers of ( especially GC- and RTX-related) AE during the 52 week study, Proportion of patients in GC free remission 1.5 years after RTX/PCB infusion, Proportion of patients in GC free remission 2 years after RTX/PCB infusion, The number of disease relapses/recurrences up to 2 years., The proportion of patients with a disease relapse/recurrence at 2 years., The proportion of patients lost-to follow-up and the reason for loss to follow-up at 1.5 and 2 years, The proportion of patients that had a (different) DMARD started (and reason for starting the DMARD) at 1.5 and 2 years, The proportion (and number) of patients in which a (concomitant) rheumatic (inflammatory) disease was diagnosed at 1.5 and 2 years

Source: https://euclinicaltrials.eu/ctis-public/view/2024-513545-37-00